EU clinical trial 2024-513285-19-00: KO-2806 Monotherapy and Combination Therapies in Advanced Solid Tumors
Protocol code: KO-2806-001
Sponsor: Kura Oncology Inc. (Pharmaceutical company). Phase: Human Pharmacology (Phase I)- First administration to humans. Countries: Italy (ongoing, recruiting), France (ongoing, recruiting), Germany (ongoing, recruiting), Spain (ongoing, recruiting).
Therapeutic area(s): Diseases [C] - Neoplasms [C04]
Gender: Female, Male. Age: 18-64 years, 65+ years. Enrolment: 66.
Status: Ongoing, recruiting. Start date (EU): 2025-03-14. Decision date: 2025-01-30. Results received: No. Last updated: 2026-08-04.
Decision dates by country: DE: 2025-02-03, IT: 2025-02-04, FR: 2025-01-31, ES: 2025-04-11

Condition(s): Non- Small Cell Lung Cancer (NSCLC), Colorectal Cancer, Renal Cell Carcinoma, Pancreatic Ductal Adeno Carcinoma

Source: https://euclinicaltrials.eu/ctis-public/view/2024-513285-19-00